EU clinical trial 2022-503013-32-00: IBCSG 67-22 PREcoopERA: A Window-of-Opportunity trial of giredestrant +/- triptorelin vs. anastrozole + triptorelin in premenopausal patients with ER-positive/HER2-negative early breast cancer.
Protocol code: 67-22 PREcoopERA
Sponsor: ETOP IBCSG Partners Foundation (Laboratory/Research/Testing facility). Phase: Therapeutic exploratory (Phase II). Countries: Spain (ended), Germany (ended), Italy (ended), Sweden (ended), Hungary (ended), Ireland (ended), France (ended).
Therapeutic area(s): Diseases [C] - Neoplasms [C04]
Gender: Female. Age: 18-64 years. Enrolment: 175.
Status: Ended. Start date (EU): 2024-01-29. End date (EU): 2025-09-18. Decision date: 2023-11-28. Results received: No. Last updated: 2025-08-26.
Decision dates by country: SE: 2023-12-04, IT: 2023-12-01, HU: 2023-12-01, FR: 2024-09-18, DE: 2023-11-29, IE: 2024-04-12, ES: 2023-11-28

Condition(s): ER-positive/HER2-negative early breast cancer
Product: Pamorelin® LA 3,75 mg Pulver und Lösungsmittel zur Herstellung einer Depot-Injektionssuspension, RO7197597, ANASTROZOLE ACCORD 1 mg, comprimé pelliculé

Primary endpoint: The primary endpoint is the change in Ki-67 (Ki-67-labeling index, the percentage of immunostaining cells measured by IHC in the central laboratory) between a pre-treatment tumor biopsy and a post-treatment tumor re-biopsy (analyzed on the natural logarithmic scale).
Endpoint(s): • Complete cell cycle arrest (CCCA), defined as Ki-67 ≤2.7% on post-treatment tumor re-biopsy, by visual image analysis. • Adverse events according to CTCAE v5.0.

Source: https://euclinicaltrials.eu/ctis-public/view/2022-503013-32-00